EU clinical trial 2022-502665-15-00: Phase II study of (early) combination salvage therapy with Venetoclax and intensified Decitabine in Relapsed/Refractory AML
Protocol code: VenSwitch
Sponsor: Universitaetsklinikum Tuebingen (Hospital/Clinic/Other health care facility). Phase: Therapeutic exploratory (Phase II). Countries: Germany (ongoing, recruiting).
Therapeutic area(s): Diseases [C] - Hemic and Lymphatic Diseases [C15]
Gender: Female, Male. Age: 18-64 years, 65+ years. Enrolment: 27.
Status: Ongoing, recruiting. Start date (EU): 2023-10-26. Decision date: 2023-05-04. Results received: No. Last updated: 2026-06-18.

Condition(s): acute myeloid leukemia (AML)
Product: Venclyxto 100 mg film-coated tablets, Dacogen 50 mg powder for concentrate for solution for infusion.

Primary endpoint: • Hematologic remission (defined as morphologically leukemia-free state (MLFS), complete remission (CR), complete remission with incomplete hematological recovery (CRi) or complete remission with partial hematological recovery (CRh)) as best response in bone marrow aspiration cytomorphology*) after one or two cycles of Decitabine/Venetoclax.
Endpoint(s): Safety and feasibility of combining Venetoclax with a timedense immediate application of the hypomethylating agent Decitabine evaluated by the incidence of CTCAEs ≥ grade 3 until day 30 after therapy application and times to hematopoietic recovery (absolute neutrophil counts ≥0.5 and ≥1.0 x 109/L; platelets ≥50 and ≥100 x 109/L) after each chemotherapy treatment cycle, defined as the time from the start of the cycle until recovery, MRD assessment (MRD including qPCR for established MRD markers and NGS for exploratory MRD markers) at each remission assessment, Infectious complications CTCAEs >=grade 3, Time-to-transplant from diagnosis of primary induction failure to infusion of allogeneic stem cells, ECOG prior to start of potential conditioning for transplant, PFS and OS at Follow-up Visit (100 days after EOT) and time dependent, Mortality at 30 days post start of salvage therapy, Quality of life assessment at screening (additional at the end of each cycle Venetoclax/Decitabine) and at the end of the trial (follow up), Hospitalisation days, defined as days in hospital from day 1 of therapy until day 30 after EOT

Source: https://euclinicaltrials.eu/ctis-public/view/2022-502665-15-00